EU clinical trial 2022-501427-24-00: (Summit) A Multi-Part, Randomized, Double-Blind, Placebo-Controlled Phase 2 Clinical Study of the Safety and Efficacy of CGT9486 in Subjects with NonAdvanced Systemic Mastocytosis
Protocol code: CGT9486-21-202
Sponsor: Cogent Biosciences Inc. (Pharmaceutical company). Phase: Therapeutic exploratory (Phase II). Countries: Netherlands (ongoing, recruitment ended), Czechia (ongoing, recruitment ended), France (ongoing, recruitment ended), Spain (ongoing, recruitment ended), Norway (ongoing, recruitment ended), Poland (ongoing, recruitment ended), Germany (ongoing, recruitment ended), Italy (ongoing, recruitment ended), Austria (ended), Belgium (ongoing, recruitment ended), Ireland (ongoing, recruitment ended), Greece (ended).
Therapeutic area(s): Diseases [C] - Immune System Diseases [C20]
Gender: Female, Male. Age: 18-64 years, 65+ years. Enrolment: 128.
Start date (EU): 2023-04-25. Decision date: 2023-02-27. Results received: No. Last updated: 2026-03-18.
Decision dates by country: GR: 2023-07-10, AT: 2023-06-26, NL: 2023-02-27, DE: 2023-05-22, NO: 2023-03-01, ES: 2023-03-01, PL: 2023-03-06, CZ: 2023-03-03, IT: 2023-03-02, IE: 2023-06-23, BE: 2023-06-23, FR: 2023-02-27

Condition(s): Nonadvanced Systemic Mastocytosis
Product: CGT9486, CGT9486, Placebo matching CGT9486

Primary endpoint: Part 1: Safety assessments (incidence of adverse events [AEs], SAEs); AEs leading to dose modifications; pharmacokinetics (PK) and pharmacodynamic (PD) markers; improvement in symptoms of disease based on PRO measures, Part 2: Week 24 mean absolute change from baseline in an MS2D2 score, Part 3: TEAEs, SAEs, AEs leading to dose modifications; change from baseline in laboratory and ECG results
Endpoint(s): Part 1: TEAEs, SAEs, AEs leading to dose modifications; change from baseline in laboratory and electrocardiogram (ECG) results, Part 2: Proportion of subjects who had at least 50% reduction in serum tryptase

Source: https://euclinicaltrials.eu/ctis-public/view/2022-501427-24-00